EU clinical trial 2026-526116-36-00: A Phase 1a/1b, multicenter, open-label study evaluating the safety, tolerability, pharmacokinetics, and preliminary antitumor activity of PLN-101095 alone and in combination with pembrolizumab in adults with advanced or metastatic solid tumors following progression on immune checkpoint inhibitor therapy
Protocol code: PLN-101095-ONC-101
Sponsor: Pliant Therapeutics Inc. (Pharmaceutical company). Phase: Human Pharmacology (Phase I)- Other. Countries: Spain (authorised, recruitment pending).
Therapeutic area(s): Diseases [C] - Neoplasms [C04]
Gender: Female, Male. Age: 18-64 years, 65+ years. Enrolment: 15.
Status: Authorised, recruitment pending. Decision date: 2026-07-29. Results received: No. Last updated: 2026-07-29.

Condition(s): Advanced or metastatic solid tumours

Source: https://euclinicaltrials.eu/ctis-public/view/2026-526116-36-00